EU clinical trial 2025-522578-35-00: A MULTICENTER, RANDOMIZED, DOUBLE-BLIND, PLACEBO-CONTROLLED, PARALLEL-GROUP, DOSE-RANGING STUDY TO EVALUATE THE EFFICACY, SAFETY, PHARMACOKINETICS, AND PHARMACODYNAMICS OF GALVOKIMIG IN ADULT STUDY PARTICIPANTS WITH MODERATE TO SEVERE ATOPIC DERMATITIS
Protocol code: ATD002
Sponsor: UCB Biopharma (Pharmaceutical company). Phase: Therapeutic exploratory (Phase II). Countries: Bulgaria (ongoing, recruiting), Czechia (ongoing, recruiting), Germany (ongoing, recruiting), Poland (ongoing, recruiting), Hungary (ongoing, recruiting).
Therapeutic area(s): Diseases [C] - Skin and Connective Tissue Diseases [C17]
Gender: Female, Male. Age: 18-64 years, 65+ years. Enrolment: 92.
Status: Ongoing, recruiting. Start date (EU): 2026-03-30. Decision date: 2026-03-09. Results received: No. Last updated: 2026-08-07.
Decision dates by country: PL: 2026-03-13, BG: 2026-03-11, DE: 2026-03-09, CZ: 2026-03-10, HU: 2026-03-12

Condition(s): Atopic Dermatitis
Product: Galvokimig, Placebo matching Test 0.9% sodium chloride solution for injection

Primary endpoint: Percentage of participants with Eczema Area and Severity Index (EASI)75 response at Week 16
Endpoint(s): Percentage of Participants with validated Investigator Global Assessment (vIGA) response at Week 16, Change from Baseline in weekly averaged Peak Pruritus Numerical Rating Scale (PP-NRS) at Week 16, Incidence of Treatment-Emergent (TE) Adverse Events (AE), Incidence of TE Serious Adverse Events (SAEs)

Source: https://euclinicaltrials.eu/ctis-public/view/2025-522578-35-00